EU clinical trial 2024-513884-20-00: A multi-center, open-label, uncontrolled, single-arm, extension study to determine the long-term safety and tolerability of oral lucerastat in adult subjects with Fabry disease.
Protocol code: ID-069A302
Sponsor: Idorsia Pharmaceuticals Ltd. (Pharmaceutical company). Phase: Therapeutic confirmatory (Phase III). Countries: Austria (ended), France (ongoing, recruitment ended), Germany (ongoing, recruitment ended), Norway (ongoing, recruitment ended), Poland (ongoing, recruitment ended), Belgium (ongoing, recruitment ended), Spain (ongoing, recruitment ended).
Therapeutic area(s): Diseases [C] - Nutritional and Metabolic Diseases [C18]
Gender: Female, Male. Age: 18-64 years, 65+ years. Enrolment: 45.
Start date (EU): 2019-03-13. Decision date: 2024-11-05. Results received: No. Last updated: 2025-11-20.
Decision dates by country: AT: 2024-11-08, BE: 2024-11-07, PL: 2024-11-07, DE: 2024-11-07, FR: 2024-11-06, NO: 2024-11-05, ES: 2024-11-05

Condition(s): Fabry disease
Product: Lucerastat

Primary endpoint: Treatment-emergent AEs and SAEs

Source: https://euclinicaltrials.eu/ctis-public/view/2024-513884-20-00